EU clinical trial 2024-516488-99-00: Coadministration of GA2 Sporozoites With Adjuvants (CoGA)
Sponsor: Leids Universitair Medisch Centrum (LUMC) (Hospital/Clinic/Other health care facility). Phase: Human Pharmacology (Phase I)- First administration to humans. Countries: Netherlands (ongoing, recruiting).
Therapeutic area(s): Diseases [C] - Parasitic Diseases [C03]
Gender: Female, Male. Age: 18-64 years. Enrolment: 66.
Status: Ongoing, recruiting. Start date (EU): 2023-02-03. Decision date: 2024-11-12. Results received: No. Last updated: 2025-09-04.

Condition(s): Falciparum malaria

Source: https://euclinicaltrials.eu/ctis-public/view/2024-516488-99-00